EU clinical trial 2025-523347-35-00: A Phase 3b/4 Randomized, Open-label, Efficacy Assessor-Blinded Study, to Evaluate the Efficacy and Safety of Upadacitinib for the Treatment of Adult Subjects with Moderate to Severe Atopic Dermatitis and Inadequate Response to Dupilumab (SWITCH-UP)
Protocol code: M24-601
Sponsor: AbbVie Deutschland GmbH & Co. KG (Pharmaceutical company). Phase: Phase III and phase IV (Integrated). Countries: Spain (ongoing, recruiting), Italy (ongoing, recruiting), Romania (ongoing, recruiting).
Therapeutic area(s): Diseases [C] - Immune System Diseases [C20]
Gender: Female, Male. Age: 18-64 years. Enrolment: 50.
Status: Ongoing, recruiting. Start date (EU): 2026-03-05. Decision date: 2026-02-02. Results received: No. Last updated: 2026-05-07.
Decision dates by country: RO: 2026-02-23, ES: 2026-02-02, IT: 2026-02-18

Condition(s): Atopic Dermatitis
Product: DUPILUMAB, Upadacitinib, Upadacitinib

Primary endpoint: Participants who achieve at least a 90% reduction in Eczema Area and Severity Index from Baseline (EASI 90) at Week 8
Endpoint(s): Percentage of participants who achieve a Worst Pruritus Numerical Rating Scale of 0 or 1 (WP-NRS 0/1) at Week 8, Participants who simultaneous achieve at least a 90% reduction in Eczema Area and Severity Index from Baseline (EASI 90) and Worst Pruritus Numerical Rating Scale of 0 or 1 (WP-NRS 0/1) at Week 8, Percentage of participants achieving worst pruritus numerical rating scale (WP-NRS) 0/1 at Week 4

Source: https://euclinicaltrials.eu/ctis-public/view/2025-523347-35-00